EU clinical trial 2024-517241-13-00: Evaluation of treatment PERSOnalization based on its therapeutic monitoring in patients with metastatic colorectal cancer treated with regorafenib
Protocol code: 35RC20_9803_RePERSO
Sponsor: Centre Hospitalier Universitaire De Rennes (Hospital/Clinic/Other health care facility). Phase: Therapeutic exploratory (Phase II). Countries: France (ended).
Therapeutic area(s): Diseases [C] - Digestive System Diseases [C06]
Gender: Female, Male. Age: 18-64 years. Enrolment: 110.
Status: Ended. Start date (EU): 2021-10-22. End date (EU): 2025-04-11. Decision date: 2024-09-26. Results received: No. Last updated: 2025-02-07.

Condition(s): metastatic colorectal cancer
Product: Stivarga 40 mg film-coated tablets

Primary endpoint: The primary endpoint is the overall survival defined as the time from inclusion to death from any cause. Two groups of patients will be defined a posteriori based on trough concentration of regorafenib and active metabolites: • Group with "optimal exposure": Csum on C1 and/or Csum on C2 within the range [2.5 – 5.5 mg/L]. • Group with "non optimal exposure": Csum on C1 and Csum on C2 outside the range [2.5 – 5.5 mg/L].
Endpoint(s): 10-month survival rate (defined as the percentage of patients alive 10 months after inclusion), Objective response Rate (ORR) according to RECIST 1.1 and assessed by the investigators. ORR is be defined as the rate of patients with complete or partial response, Disease Control Rate (DCR) according to RECIST 1.1 and assessed by the investigators. DCR is defined as the rate of patients with complete response, partial response or stable disease, Progression-free survival (PFS) according to RECIST 1.1, assessed by the investigators. PFS is defined as the time from inclusion to date of first observed disease progression (radiological or clinical) or death due to any cause, if death occurs before progression is documented. The actual date that the tumor scan was performed will be used for this calculation. PFS for patients without disease progression or death at the time of analysis will be censored at the last date of tumor evaluation, Percentage of patients with significant toxicities (≥ grade 3). AEs will be assessed from inclusion to 28 day after the discontinuation of the study drug and classified according to the National Cancer Institute Common Terminology Criteria for Adverse Events (NCI-CTCAE) version 5.0, Percentage of patients with “optimal exposure” – i.e. with Csum at D15 within the range [2.5 – 5.5 mg/L]) – at cycle 1 and cycle 2, Overall survival for the half of patients with a low ratio of plasma concentration of M-2 C2/C1 compared to the overall survival for the half of patients with a high ratio of plasma concentration of M-2 C2/C1, Genetic polymorphisms in gene involved in regorafenib metabolism and plasma concentrations of regorafenib and its metabolites, Body composition will be determined on Computerized Tomography scan (CT-scan) imaging done at baseline and for tumor response evaluation during treatment., Plasma metabolomics biomarkers (quantitative and qualitative composition) within 7 days before Day 1, at D15C1, D15C2 and end of treatment

Source: https://euclinicaltrials.eu/ctis-public/view/2024-517241-13-00